EU clinical trial 2024-517738-16-00: FIRST-IN-HUMAN OPEN-LABEL MULTICENTRE CLINICAL TRIAL TO EVALUATE THE SAFETY AND EFFICACY OF EPICARDIAL IMPLANTATION OF COLLAGEN MEMBRANES WITH ALLOGENEIC ADIPOSE-DERIVED STEM CELLS IN PATIENTS WITH ISCHAEMIC LEFT VENTRICULAR DYSFUNCTION SCHEDULED TO UNDERGO CORONARY REVASCULARISATION SURGERY
Protocol code: CARDIOMESH II
Sponsor: Viscofan Espana S.L.U. (Pharmaceutical company). Phase: Human Pharmacology (Phase I)- First administration to humans. Countries: Poland (ended).
Therapeutic area(s): Diseases [C] - Cardiovascular Diseases [C14]
Gender: Female, Male. Age: 18-64 years, 65+ years. Enrolment: 10.
Status: Ended. End date (EU): 2025-10-01. Decision date: 2024-11-05. Results received: No. Last updated: 2025-04-24.

Condition(s): ventricular failure caused by ischemic heart disease

Source: https://euclinicaltrials.eu/ctis-public/view/2024-517738-16-00